EU clinical trial 2024-512502-26-00: A Randomized Phase II Trial assessing Trimodality Therapy With or Without Adjuvant Durvalumab (MEDI4736) to Treat Patients with Muscle-Invasive Bladder Cancer
Protocol code: BL.13
Sponsor: Fundacion Cris De Investigacion Para Vencer El Cancer (Laboratory/Research/Testing facility). Phase: Therapeutic exploratory (Phase II). Countries: Spain (ongoing, recruitment ended).
Therapeutic area(s): Diseases [C] - Neoplasms [C04]
Gender: Female, Male. Age: 18-64 years, 65+ years. Enrolment: 80.
Status: Ongoing, recruitment ended. Start date (EU): 2019-11-06. Decision date: 2024-04-03. Results received: No. Last updated: 2024-06-24.

Condition(s): Muscle-invasive bladder cancer
Product: IMFINZI 50 mg/mL concentrate for solution for infusion.

Primary endpoint: Disease-free survival. From randomization to either recurrent (local or distant) bladder cancer, a new primary bladder cancer or death from any cause
Endpoint(s): Locoregional Control Rate (LCR) Bladder-intact Disease-Free Survival Overall Survival Evaluable for Adverse Events Evaluable for Quality of Life Assessment Evaluable for Economic Analysis

Source: https://euclinicaltrials.eu/ctis-public/view/2024-512502-26-00